EU clinical trial 2026-525700-10-00: A Study to Evaluate the Safety, Tolerability, Pharmacokinetics and Pharmacodynamics of ST‑905‑AG1 in Healthy Volunteers
Protocol code: ST905-SM-102
Sponsor: Syremis Therapeutics Ltd. (Pharmaceutical company). Phase: Human Pharmacology (Phase I)- First administration to humans. Countries: France (ongoing, recruiting).
Therapeutic area(s): Psychiatry and Psychology [F] - Mental Disorders [F03]
Gender: Female, Male. Age: 18-64 years. Enrolment: 280.
Status: Ongoing, recruiting. Start date (EU): 2026-06-08. Decision date: 2026-06-08. Results received: No. Last updated: 2026-06-08.

Condition(s): Schizophrenia

Source: https://euclinicaltrials.eu/ctis-public/view/2026-525700-10-00